EU clinical trial 2024-516363-92-00: A Phase 3, Randomized, Double-Blind, Placebo-Controlled, Parallel Group Study to Evaluate the Safety and Efficacy of KarXT for the Treatment of Psychosis Associated with Alzheimer’s Disease (ADEPT-4)
Protocol code: CN0120056
Sponsor: Bristol-Myers Squibb Services Unlimited Company (Pharmaceutical company). Phase: Therapeutic confirmatory (Phase III). Countries: Bulgaria (ongoing, recruiting), Croatia (ongoing, recruiting), Romania (ongoing, recruiting), Germany (ended), Belgium (ended), France (ongoing, recruiting), Slovakia (ongoing, recruiting), Spain (ongoing, recruiting), Portugal (ongoing, recruiting), Hungary (ongoing, recruiting), Greece (ongoing, recruiting), Italy (ongoing, recruiting), Poland (ongoing, recruiting).
Therapeutic area(s): Diseases [C] - Nervous System Diseases [C10]; Psychiatry and Psychology [F] - Mental Disorders [F03]
Gender: Female, Male. Age: 18-64 years, 65+ years. Enrolment: 102.
Start date (EU): 2025-04-08. Decision date: 2025-03-24. Results received: No. Last updated: 2026-08-05.
Decision dates by country: BE: 2025-03-25, DE: 2025-03-28, SK: 2025-03-24, BG: 2025-03-27, PT: 2025-03-24, IT: 2025-03-27, HU: 2025-03-25, HR: 2025-03-31, FR: 2025-04-01, ES: 2025-03-26, RO: 2025-03-31, GR: 2025-03-28, PL: 2025-03-27

Condition(s): Psychosis Associated with Alzheimer’s Disease
Product: KarXT, KarXT, KarXT, KarXT, Placebo, KarXT

Primary endpoint: The main endpoint is the change from Baseline to End of Treatment in NPI-C: H+D score.
Endpoint(s): The key secondary endpoint is the change from Baseline to End of Treatment on CGI-S score.

Source: https://euclinicaltrials.eu/ctis-public/view/2024-516363-92-00